EU clinical trial 2024-518302-41-00: CARPEUS : Effect of Carvedilol on the portosystemic gradient as measured by endoscopic ultrasound
Protocol code: AOI 2023 POINCLOUX
Sponsor: University Hospital Of Clermont-Ferrand (Hospital/Clinic/Other health care facility). Phase: Therapeutic exploratory (Phase II). Countries: France (ongoing, recruiting).
Therapeutic area(s): Diseases [C] - Digestive System Diseases [C06]
Gender: Female, Male. Age: 18-64 years, 65+ years. Enrolment: 30.
Status: Ongoing, recruiting. Start date (EU): 2025-04-16. Decision date: 2025-01-29. Results received: No. Last updated: 2025-08-25.

Condition(s): cirrhotic portal hypertension
Product: CARVEDILOL ARROW 6,25 mg, comprimé pelliculé sécable

Primary endpoint: Hemodynamic response (binary efficacy criterion) at one month, defined by a decrease of at least 10% in the echo-endoscopic portosystemic gradient compared to the baseline value measured at inclusion.
Endpoint(s): Top ten side effects of beta-blockers reported in the literature, and percentage of patients who discontinue treatment due to side effects., Digestive bleeding linked to rupture of esophageal or gastric varices within three months of starting treatment., Biological and elastometric parameters measured before and after taking Carvedilol for three months.

Source: https://euclinicaltrials.eu/ctis-public/view/2024-518302-41-00